EU clinical trial 2023-503699-25-00: A Multicenter, Randomized, Double-blind, Placebo-controlled, Phase 3 Study to Evaluate the Efficacy, Safety, and Tolerability of BMS-986278 in Participants with Progressive Pulmonary Fibrosis
Protocol code: IM0271015
Sponsor: Bristol-Myers Squibb Services Unlimited Company (Pharmaceutical company). Phase: Therapeutic confirmatory (Phase III). Countries: Denmark (ongoing, recruitment ended), Portugal (ongoing, recruitment ended), Netherlands (ongoing, recruitment ended), Finland (ongoing, recruitment ended), Germany (ongoing, recruitment ended), Italy (ongoing, recruitment ended), Czechia (not authorised), Spain (ongoing, recruitment ended), Poland (ongoing, recruitment ended), France (ongoing, recruitment ended), Greece (ongoing, recruitment ended), Ireland (ongoing, recruitment ended), Belgium (ongoing, recruitment ended), Hungary (ongoing, recruitment ended), Austria (ongoing, recruitment ended).
Therapeutic area(s): Diseases [C] - Respiratory Tract Diseases [C08]
Gender: Female, Male. Age: 18-64 years, 65+ years. Enrolment: 249.
Start date (EU): 2024-07-15. Decision date: 2024-06-10. Results received: No. Last updated: 2026-07-28.
Decision dates by country: CZ: 2024-06-14, AT: 2024-06-17, DK: 2024-06-10, FR: 2024-06-12, IE: 2024-06-14, NL: 2024-06-10, BE: 2024-06-10, PL: 2024-06-14, PT: 2024-06-12, DE: 2024-06-13, ES: 2024-06-11, FI: 2024-06-11, IT: 2024-06-11, GR: 2024-06-17, HU: 2024-06-17

Condition(s): Progressive Pulmonary Fibrosis
Product: LPA1 antagonist, Placebo for BMS-986278, LPA1 antagonist

Primary endpoint: Absolute change in FVC (mL) from baseline at Week 52.
Endpoint(s): Disease progression 4-component composite endpoint: Time to first disease progression event from Day 1 through the Primary Endpoint Visit., Change in walking distance measured in 6MWT from baseline at Week 52.

Source: https://euclinicaltrials.eu/ctis-public/view/2023-503699-25-00